EU clinical trial 2025-524129-42-00: Methotrexate in paediatric and adolescent Crohn’s disease: an observational study
Sponsor: Amsterdam UMC Stichting (Patient organisation/association). Phase: Therapeutic use (Phase IV). Countries: Netherlands (authorised, recruitment pending).
Therapeutic area(s): Diseases [C] - Digestive System Diseases [C06]
Gender: Female, Male. Age: 0-17 years, 18-64 years. Enrolment: 215.
Status: Authorised, recruitment pending. Decision date: 2026-04-11. Results received: No. Last updated: 2026-07-30.
Decision dates by country: NL: 2026-05-05

Condition(s): Crohn’s disease
Product: Methotrexaat Sandoz 10 mg, tabletten, Methotrexaat Teva 25,0 mg, Oplossing voor injectie in een voorgevulde pen, Methotrexaat Sandoz 2,5 mg, tabletten

Primary endpoint: [PK] RBC MTX-PG levels at 1,3 and 6 months [PD] Drug survival; defined as the cumulative incidence of MTX monotherapy discontinuation during the first year due to treatment failure and/or toxicity. Treatment failure includes need for systemic corticosteroids, biologicals, JAK inhibitors, thiopurine therapy and/or surgery due to CD inflammation because of a flare of CD. Locally applied corticosteroids or dose escalation of MTX will not be considered as treatment failure.
Endpoint(s): -Sex -Age -Weight -Length -BMI -Body Surface Area (BSA) -Smoking status; including vaping and parental smoking status -Extra-intestinal manifestations -Comorbidity -Previous IBD medication -Co-medication - Renal function -MTX dose -Route of administration of MTX -Folic acid dose -Adherence, PBMC MTX-PG levels at 1,3,6 months (academic hospitals) and RBC MTX-PG levels at 1,3 and 6 months, -DNA SNP’s -FPGS activity -Transcriptome-wide RNA sequencing -Plasma cotinine (µg/L) -Erythrocyte folate (nmol/L) -Plasma homocysteine (µmol/L) -Plasma metabolomics, -Faecal microbiome -Faecal metabolome, - Drug survival due to treatment failure -Disease activity scores at baseline, 1,3,6 and 12 months -Faecal calprotectin at baseline, 1,3,6 and 12 months - CRP at baseline 1,3,6 and 12 months - SIBDQ at baseline, 1,3,6 and 12 months, - Drug survival; Defined as the cumulative incidence of MTX monotherapy discontinuation during the first year due to toxicity. -Whole blood count (CBC) at 1,3,6,12 months *routine -Liver blood test at 1,3,6,12 months *routine - MISS questionnaire at 1,3,6 and 12 months and if patients stop MTX treatment (tolerance defined as <6), Clinical, genetic and metabolic determinants influencing MTX-PG concentrations and efficacy., Clinical, genetic and metabolic determinants influencing MTX-PG concentrations and toxicity., Infliximab dose - Route of administration of infliximab -Infliximab induction and maintenance schedule, Infliximab levels *routine, Anti-drug-antibodies to infliximab *routine

Source: https://euclinicaltrials.eu/ctis-public/view/2025-524129-42-00